EU clinical trial 2023-507522-16-00: A Randomized, Open-Label, Multicenter Phase 3 Trial of Domvanalimab, Zimberelimab, and Chemotherapy Versus Nivolumab and Chemotherapy in Participants with Previously Untreated Locally Advanced Unresectable or Metastatic Gastric, Gastroesophageal Junction, and Esophageal Adenocarcinoma
Protocol code: STAR-221
Sponsor: Arcus Biosciences Inc. (Pharmaceutical company). Phase: Therapeutic confirmatory (Phase III). Countries: Hungary (ended), Lithuania (ended), Italy (ended), Portugal (ended), Romania (ongoing, recruitment ended), Spain (ongoing, recruitment ended), Poland (ended), France (ended), Greece (ended).
Therapeutic area(s): Diseases [C] - Neoplasms [C04]
Gender: Female, Male. Age: 18-64 years, 65+ years. Enrolment: 152.
Start date (EU): 2023-05-22. Decision date: 2024-08-29. Results received: No. Last updated: 2026-05-22.
Decision dates by country: PT: 2024-08-29, LT: 2024-09-13, HU: 2024-09-02, FR: 2024-10-18, GR: 2024-11-20, IT: 2024-09-23, RO: 2024-09-06, ES: 2024-08-30, PL: 2024-09-02

Condition(s): Metastatic Esophageal or Gastric Cancer, Esophageal or Gastric Cancer
Product: FLUOROURACIL, CAPECITABINE, Zimberelimab, OXALIPLATIN, FLUOROURACIL, CALCIUM FOLINATE, DOMVANALIMAB, NIVOLUMAB, FLUOROURACIL, CAPECITABINE

Primary endpoint: OS is defined as the length of time from date of randomization until the date of death from any cause
Endpoint(s): PFS is defined as the time from date of randomization until disease progression or death from any cause, whichever comes first, as measured per Response Evaluation Criteria in Solid Tumors version 1.1 (RECIST 1.1) as assessed by the investigator, Time to first symptom deterioration in the FACT-Ga gastric cancer subscale., Objective response rate (ORR) is defined as the proportion of participants who have achieved confirmed complete response (CR) or confirmed partial response (PR) to study therapy as assessed by the investigator according to RECIST 1.1, Duration of response (DOR) is measured from the time of first confirmed response (CR or PR as measured by RECIST v1.1) as assessed by the investigator, until the date of first documented disease progression or death, whichever comes first., 5. The incidence and severity of adverse events (AEs) and serious adverse events (SAEs), and any clinically meaningful trends in safety parameters

Source: https://euclinicaltrials.eu/ctis-public/view/2023-507522-16-00